EU clinical trial 2024-514046-37-00: A Phase 3, Randomized, Double-Blind, Active-Controlled Study to Evaluate a Switch to an Oral Weekly Islatravir/Lenacapavir Regimen in People With HIV-1 Who Are Virologically Suppressed on Bictegravir/Emtricitabine/Tenofovir (B/F/TAF).
Protocol code: GS-US-563-5925
Sponsor: Gilead Sciences Inc. (Pharmaceutical company). Phase: Therapeutic confirmatory (Phase III). Countries: Spain (ongoing, recruitment ended), Germany (ongoing, recruitment ended), France (ongoing, recruitment ended).
Therapeutic area(s): Diseases [C] - Virus Diseases [C02]
Gender: Female, Male. Age: 18-64 years, 65+ years. Enrolment: 87.
Status: Ongoing, recruitment ended. Start date (EU): 2025-01-16. Decision date: 2024-12-10. Results received: No. Last updated: 2026-01-19.
Decision dates by country: FR: 2024-12-10, DE: 2024-12-10, ES: 2024-12-13

Condition(s): HIV-1 Infection
Product: Biktarvy 50 mg/200 mg/25 mg film-coated tablets, PTM ISL/LEN, ISLATRAVIR/LENACAPAVIR, ISLATRAVIR/LENACAPAVIR, PTM Biktarvy

Primary endpoint: The proportion of participants with HIV-1 RNA ≥ 50 copies/mL at Week 48 as determined by the United States (US) Food and Drug Administration (FDA)-defined snapshot algorithm [Time Frame: Week 48]
Endpoint(s): Proportion of Participants With HIV-1 RNA ≥ 50 Copies/mL at Week 96 as Determined by the US FDA-Defined Snapshot Algorithm, Proportion of Participants with HIV-1 RNA < 50 Copies/mL at Weeks 48 and 96 as Determined by the US FDA-Defined Snapshot Algorithm, The change from baseline in CD4+ T-cell count at Weeks 48 and 96, Proportion of Participants Discontinuing ISL/LEN due to Treatment-Emergent Adverse Events (AEs)

Source: https://euclinicaltrials.eu/ctis-public/view/2024-514046-37-00